EU clinical trial 2026-526016-36-00: A neuropsychobiological approach to optimize patient selection for GLP-1-based pharmacotherapy for weight management across the binge eating spectrum
Protocol code: SEM-BEAT
Sponsor: UZ Leuven (Hospital/Clinic/Other health care facility). Phase: Therapeutic use (Phase IV). Countries: Belgium (authorised, recruitment pending).
Therapeutic area(s): Diseases [C] - Nutritional and Metabolic Diseases [C18]
Gender: Female, Male. Age: 18-64 years. Enrolment: 96.
Status: Authorised, recruitment pending. Decision date: 2026-06-08. Results received: No. Last updated: 2026-06-08.

Condition(s): obesity
Product: Wegovy 2.4 mg FlexTouch solution for injection in pre-filled pen

Primary endpoint: Change in BMI after semaglutide treatment (baseline vs at 6 months of semaglutide treatment), Change in Binge Eating Scale (BES) score after semaglutide treatment (baseline vs at 6 months of semaglutide treatment)
Endpoint(s): Change in waist/hip ratio after semaglutide treatment (baseline vs at 6 months of semaglutide treatment), Change in body composition after semaglutide treatment (baseline vs at 6 months of semaglutide treatment), Changes in the following after semaglutide treatment (baseline vs at 6 months of semaglutide treatment): Gut hormone blood levels; Blood and urinary DA levels; Appetite-related sensations; DA release in the brain in response to food reward; Neural responses to food reward; Food liking, wanting, and craving; Emotional state; HR and HRV; BP; Chronic hair cortisol levels; SCFA blood levels; Cytokine blood levels; BBB/BSCFB integrity/permeability; Neuroinflammation

Source: https://euclinicaltrials.eu/ctis-public/view/2026-526016-36-00